EU clinical trial 2023-510405-18-00: An open-label, phase 2 trial to evaluate the efficacy and safety of a single intravenous administration of GNT0003 (an adeno-associated viral vector expressing the UGT1A1 transgene) following imlifidase pre-treatment in participants aged 16 years and older with severe Crigler-Najjar syndrome requiring daily phototherapy and presenting pre-existing anti-AAV8 antibodies.
Protocol code: GNT-018-IDES
Sponsor: Genethon (Laboratory/Research/Testing facility). Phase: Therapeutic exploratory (Phase II). Countries: France (ongoing, recruiting).
Therapeutic area(s): Diseases [C] - Nutritional and Metabolic Diseases [C18]
Gender: Female, Male. Age: 0-17 years, 18-64 years, 65+ years. Enrolment: 3.
Status: Ongoing, recruiting. Start date (EU): 2024-11-08. Decision date: 2024-07-17. Results received: No. Last updated: 2026-06-12.

Condition(s): Crigler-Najjar syndrome
Product: CETIRIZINE, METHYLPREDNISOLONE, LORATADINE, PREDNISONE, Idefirix 11 mg powder for concentrate for solution for infusion, AMOXICILLIN, PREDNISOLONE, rAAV8-hUGT1A1, SIROLIMUS

Primary endpoint: The proportion of participants with serum total bilirubin ≤ 300 µmol/L, 48 weeks after the GNT0003 infusion and without phototherapy from Week 16
Endpoint(s): Vital signs, physical examination; Clinically significant abnormalities in safety laboratory assessments; Electrocardiogram (ECG), Incidence of all treatment-emergent adverse events (TEAE), serious adverse events (SAE), adverse events of special interest (AESI) from imlifidase administration to 48 weeks after GNT0003 infusion., Incidence of Adverse Drug Reaction (ADR), malignancies (including liver carcinogenicity) up to 60 months after GNT0003 administration., Comparison of total anti-AAV8 IgG in serum before imlifidase infusion (s) versus prior to GNT0003 administration, Time to GNT0003 vector clearance from blood, urine, saliva, faeces, and semen (for male), Change in serum total bilirubin, in serum bilirubin/albumin ratio from baseline to Week 48, Change in serum total bilirubin, in serum bilirubin/albumin ratio from baseline to 60 months, Mean time to restart phototherapy, Change from baseline in health-related quality of life measured by SF-36 after GNT0003 administration

Source: https://euclinicaltrials.eu/ctis-public/view/2023-510405-18-00